EU clinical trial 2022-500453-16-00: Randomized phase II trial for patients with newly diagnosed low-risk multiple myeloma to evaluate the benefit of 6 cycles of isatuximab with lenalidomide/bortezomib/dexamethasone (I-VRD) followed by maintenance therapy with lenalidomide and isatuximab randomized in comparison with therapy consisting of 3 cycles of I-VRD followed by one cycle of high-dose therapy and maintenance therapy with lenalidomide and isatuximab
Protocol code: UZL22_01
Sponsor: University Medical Centre Schleswig-Holstein (Hospital/Clinic/Other health care facility). Phase: Therapeutic exploratory (Phase II). Countries: Germany (ongoing, recruitment ended).
Therapeutic area(s): Diseases [C] - Neoplasms [C04]; Diseases [C] - Cardiovascular Diseases [C14]; Diseases [C] - Hemic and Lymphatic Diseases [C15]; Diseases [C] - Immune System Diseases [C20]
Gender: Female, Male. Age: 18-64 years, 65+ years. Enrolment: 78.
Status: Ongoing, recruitment ended. Start date (EU): 2023-10-30. Decision date: 2022-11-03. Results received: No. Last updated: 2025-12-23.

Condition(s): Multiple Myeloma
Product: SARCLISA 20mg/mL concentrate for solution for infusion, SARCLISA 20mg/mL concentrate for solution for infusion, LENALIDOMIDE, DEXAMETHASONE, SARCLISA 20mg/mL concentrate for solution for infusion, LENALIDOMIDE, LENALIDOMIDE, LENALIDOMIDE, BORTEZOMIB, LENALIDOMIDE

Primary endpoint: MRD negativity combined with ≥CR (MRDneg+≥CR) at week 40 (MRD negativity measured by flow cytometry according to EuroFlow and lower than 1:10-5, ≥CR according to IMWG criteria)
Endpoint(s): OS since randomization, OS since week 40 based on MRD negativity at week 40, PFS, defined as time since randomization to disease progression after first-line treatment (study treatment), Frequency of PR, VGPR, nCR, CR, sCR as well as ORR (ORR defined as: proportion of all patients reaching PR or VGPR or nCR or CR or sCR) in arm A and B at week 40, one year after start of treatment and two years after start of treatment, PFS since week 40 based on MRDneg+≥CR at week 40, OS, PFS based and stratified by cytogenetic findings, PFS-2, defined as the time since start of second line treatment due to relapse to disease progression in relapsed patients, Time to onset of further relapse therapy after progression during first-line treatment, Global QoL score (EORTC QLQ-30) every six month after randomization, MRD negativity combined with ≥CR (MRDneg+≥CR) according to IMWG criteria at one year, and at two years after the start of induction therapy, MRD negativity at week 40 and 1 and 2 years after the start of treatment, Sustained MRD negativity between week 40 and one year, and two years after the start of induction therapy, Sustained MRD negativity combined with ≥CR response between week 40 and one year, and two years after the start of induction therapy, Type and frequency of adverse events Grade III and IV with special attention to secondary malignancies

Source: https://euclinicaltrials.eu/ctis-public/view/2022-500453-16-00